EU clinical trial 2024-516744-26-00: Acute non-severe osteomyelitis in children - Outpatient management strategy with oral antibiotic therapy compared to a standard strategy with conventional hospitalization and intravenous antibiotic therapy: randomized open-label non-inferiority study with Bayesian and medico-economic analyses.
Protocol code: APHP 180672
Sponsor: Assistance Publique Hopitaux De Paris (Hospital/Clinic/Other health care facility). Phase: Therapeutic exploratory (Phase II). Countries: France (ongoing, recruiting).
Therapeutic area(s): Diseases [C] - Bacterial Infections and Mycoses [C01]
Gender: Female, Male. Age: 0-17 years. Enrolment: 320.
Status: Ongoing, recruiting. Start date (EU): 2024-11-15. Decision date: 2024-11-15. Results received: No. Last updated: 2025-04-09.

Condition(s): acute osteomyelitis of the child
Product: CEFAZOLIN, CLOXACILLIN, CLAVULANIC ACID, AMOXICILLIN, AMOXICILLIN

Primary endpoint: Complete recovery without relapse at 6 months defined by the absence of clinical signs of osteomyelitis at 6 months AND the absence of secondary septic complications (septic arthritis, perioste abscess) before the end of antibiotic therapy AND the absence of relapse or rehospitalization for osteomyelitis in relation to the initial infection.

Source: https://euclinicaltrials.eu/ctis-public/view/2024-516744-26-00